EU clinical trial 2025-521307-43-00: Real-world effectiveness, safety and immunogenicity of chikungunya vaccination in populations at risk of severe or complicated forms: an ambispective study in La Réunion
Sponsor: Centre Hospitalier Universitaire De La Reunion (Hospital/Clinic/Other health care facility). Phase: Therapeutic use (Phase IV). Countries: France (ongoing, recruiting).
Therapeutic area(s): Diseases [C] - Virus Diseases [C02]
Gender: Female, Male. Age: 18-64 years. Enrolment: 1800.
Status: Ongoing, recruiting. Start date (EU): 2025-04-18. Decision date: 2025-04-04. Results received: No. Last updated: 2026-08-03.

Condition(s): Infectious disease: Chikungunya
Product: IXCHIQ powder and solvent for solution for injection Chikungunya vaccine (live), VIMKUNYA suspension for injection in pre-filled syringe Chikungunya vaccine (recombinant, adsorbed)

Primary endpoint: EV defined as the quotient of the difference in attack rate between unvaccinated and vaccinated participants divided by the attack rate in unvaccinated participants: EV (%): (λnv - λv) × 100 / λnv The attack rate (λ) corresponds to the cumulative incidence (%) at the end of the study follow-up period (interim analysis at 3 months at the end of the hot season, then at the end of full follow-up at 12 months) from D7 post-vaccination for the vaccinated group.
Endpoint(s): Rate of hospitalization over 24 hours and preventive fraction of hospitalization in vaccinated and unvaccinated participants, Rate of ICU hospitalization or death and preventive fraction in vaccinated and unvaccinated participants at D30 and at the end of the study, Rate of disabling complications such as arthralgia and/or chronic phenotypes (fatigue/anxiety-depression) at 3 months of inclusion, and at the end of the study.

Source: https://euclinicaltrials.eu/ctis-public/view/2025-521307-43-00